EU clinical trial 2025-520940-14-00: TIME-TO-LIA : Optimal Duration of Antibiotic Therapy in Drained Pyogenic Liver Abscess: 3 weeks versus 6 weeks, a non-inferiority trial
Sponsor: Assistance Publique Hopitaux De Paris (Hospital/Clinic/Other health care facility). Phase: Therapeutic use (Phase IV). Countries: France (authorised, recruitment pending).
Therapeutic area(s): Diseases [C] - Bacterial Infections and Mycoses [C01]; Diseases [C] - Digestive System Diseases [C06]
Gender: Female, Male. Age: 18-64 years, 65+ years. Enrolment: 456.
Status: Authorised, recruitment pending. Decision date: 2025-10-06. Results received: No. Last updated: 2025-10-06.

Condition(s): Pyogenic liver abscess
Product: MEROPENEM AND VABORBACTAM, LINEZOLID, TEDIZOLID, SULFAMETHOXAZOLE AND TRIMETHOPRIM, CEFTAZIDIME AND BETA-LACTAMASE INHIBITOR, DAPTOMYCIN, COLISTIN, METRONIDAZOLE, AMIKACIN, IMIPENEM, CILASTATIN AND RELEBACTAM

Primary endpoint: Proportion of patients with a treatment failure between the end of treatment and week 12 after the drainage of the abscess(es).
Endpoint(s): 1. Time to death of any cause, 2. Proportion of patients with digestive colonization of MDRB at inclusion and at week 12 after drainage, assessed by rectal swabs., 3. Proportion of participants with treatment failure at the end of the ATB assigned by randomization., 4. Proportion of participants with complete regression of liver abscess(es) images at week 3, week 6, and week 12 after drainage., 5. Time to hospital discharge, 6. Intercurring events between week 12 and month 6 in each group (e.g. relapse of index infection, new liver abscess(es), death from any cause), 7. Clinical, anatomical, and microbiological characteristics of the PLA. Clinical, biological and treatment characteristics of the patients., 8. Characteristics and modalities of the antibiotic therapy administered to the participant (molecules, modalities, duration)., 9. Proportion of patients with an extended ATB longer than the duration assigned by the randomisation., 10. Proportion of patients with an appropriate ATB related to the bacterial documentation (intravenous and oral)., 11. Incidence of adverse events and serious adverse events.

Source: https://euclinicaltrials.eu/ctis-public/view/2025-520940-14-00